EU clinical trial 2024-513317-12-00: A Randomized, Placebo-Controlled, Double-Blind, Multicenter, Phase 3 Trial of Quemliclustat and Chemotherapy Versus Placebo and Chemotherapy in Patients With Treatment-Naive Metastatic Pancreatic Ductal Adenocarcinoma
Protocol code: PRISM-1
Sponsor: Arcus Biosciences Inc. (Pharmaceutical company). Phase: Therapeutic confirmatory (Phase III). Countries: Austria (ongoing, recruitment ended), Poland (ended), Germany (ongoing, recruitment ended), Italy (ongoing, recruitment ended), Czechia (ongoing, recruitment ended), Spain (ongoing, recruitment ended), Netherlands (ended), France (ongoing, recruitment ended), Belgium (ongoing, recruitment ended).
Therapeutic area(s): Diseases [C] - Neoplasms [C04]
Gender: Female, Male. Age: 18-64 years, 65+ years. Enrolment: 258.
Start date (EU): 2025-02-05. Decision date: 2024-12-05. Results received: No. Last updated: 2026-08-08.
Decision dates by country: NL: 2024-12-10, PL: 2024-12-16, FR: 2025-01-24, AT: 2024-12-15, IT: 2024-12-10, ES: 2024-12-05, CZ: 2024-12-09, BE: 2024-12-10, DE: 2024-12-06

Condition(s): Pancreatic cancer, Pancreatic ductal adenocarcinoma (PDAC), Metastatic Pancreatic ductal adenocarcinoma (mPDAC)
Product: SALINE, GEMCITABINE, PACLITAXEL ALBUMIN-BOUND, GEMCITABINE, Quemliclustat, GEMCITABINE

Primary endpoint: Overall survival is defined as the time from date of randomization until the date of death from any cause.
Endpoint(s): Progression-free survival is defined as the time from the date of randomization until disease progression or death from any cause, whichever comes first, as measured per RECIST v1.1 as assessed by the investigator., Objective response rate (ORR) is defined as the proportion of patients who have achieved best overall response of confirmed complete response (CR) or partial response (PR) to study therapy as assessed by the investigator according to RECIST 1.1., Duration of response is defined as the time from the first objective response (CR or PR) until the date of first documented disease progression or death, whichever comes first, as measured per RECIST v1.1 as assessed by the investigator., Disease control rate is defined as the proportion of patients who have achieved confirmed CR, confirmed PR, or stable disease for ≥ 8 weeks from the date of randomization, as assessed by the investigator according to RECIST 1.1., The incidence and severity of adverse events and serious adverse events, and any clinically meaningful trends in safety parameters.

Source: https://euclinicaltrials.eu/ctis-public/view/2024-513317-12-00